EU clinical trial 2023-505635-13-00: 230LE306 (EMERALD): A Multicenter, Randomized, Dose-Blind, Phase 3 Long-Term Extension Study to Evaluate Continuous Safety and Efficacy of BIIB059 in Adult Participants with Active Systemic Lupus Erythematosus (SLE)
Protocol code: 230LE306
Sponsor: Biogen Idec Research Limited (Pharmaceutical company). Phase: Therapeutic confirmatory (Phase III). Countries: France (ended), Netherlands (ended), Belgium (ongoing, recruiting), Bulgaria (ongoing, recruiting), Czechia (ongoing, recruiting), Poland (ongoing, recruiting), Spain (ongoing, recruiting), Sweden (ended), Germany (ended), Italy (ongoing, recruiting), Greece (ongoing, recruiting), Hungary (ongoing, recruiting), Romania (ongoing, recruiting).
Therapeutic area(s): Diseases [C] - Immune System Diseases [C20]
Gender: Female, Male. Age: 18-64 years, 65+ years. Enrolment: 279.
Start date (EU): 2022-06-10. Decision date: 2024-07-23. Results received: No. Last updated: 2026-04-14.
Decision dates by country: FR: 2024-07-29, SE: 2024-07-23, NL: 2024-07-23, DE: 2024-07-26, GR: 2024-08-22, PL: 2024-08-04, HU: 2024-07-25, ES: 2024-07-23, BG: 2024-07-29, CZ: 2024-09-09, BE: 2024-07-26, IT: 2024-08-12, RO: 2024-07-29

Condition(s): Systemic lupus erythematosus
Product: BIIB059, Biib059 placebo is a sterile liquid for injection. the formulation composition of the placebo is identical to that of biib059 drug product minus the active ingredient.

Primary endpoint: Incidence of Treatment Emergent Adverse Events (TEAEs), Number of Serious Adverse Events (SAEs)
Endpoint(s): Proportion of participants who achieved an SRI-4 response by visit, Proportion of participants with at least 4 joints (both swollen and tender) at baseline who achieved a Joint-50 response by visit, Proportion of participants with a CLASI-A score ≥ 10 at baseline who achieved a CLASI-50, CLASI-70, and CLASI-90 response by visit, Proportion of participants who achieved a BICLA response by visit 4, Annualized severe SFI Flare Rate where severe flare is defined using the SFI definition, Percentage of time spent in LLDAS 5, Proportion of participants with sustained LLDAS, Duration of sustained LLDAS as defined by the number of visits in LLDAS, Annual change from baseline value from the parent Phase 3 studies in SDI score, Cumulative exposure to OCS over time, Proportion of participants with OCS ≤ 7.5 mg by visit, Proportion of participants with OCS ≤ 5 mg by visit, Participant-reported outcome measures: LupusQoL, SF-36 (Acute Version), EQ-5D-3L, FACIT-Fatigue, PHQ-9, WPAI:Lupus, and PtGA, Change in standard laboratory parameters and ECG results, Incidence of antibodies to litifilimab

Source: https://euclinicaltrials.eu/ctis-public/view/2023-505635-13-00